EU clinical trial 2024-511713-38-00: A Phase IIa, Multicenter, Randomized, Controlled, Open label Study to Evaluate the Efficacy of SENS-401 to Prevent the Ototoxicity induced by Cisplatin in Adult Subjects with a Neoplastic Disease
Protocol code: SENS-401-202
Sponsor: Sensorion (Pharmaceutical company). Phase: Therapeutic exploratory (Phase II). Countries: France (ended).
Therapeutic area(s): Diseases [C] - Otorhinolaryngologic Diseases [C09]
Gender: Female, Male. Age: 18-64 years, 65+ years. Enrolment: 48.
Status: Ended. Start date (EU): 2022-12-30. End date (EU): 2025-06-11. End date: 2025-06-12. Decision date: 2024-08-20. Results received: Yes. Last updated: 2024-12-13.

Condition(s): Cisplatine induced hearing loss
Product: Arazasetron besylate

Primary endpoint: Change from baseline of the average of the hearing threshold of 3 contiguous hearing frequencies assessed with a 0.5-12.5 kHz audiogram 4 weeks after the completion of the last cisplatin treatment in each eligible ear of each subject.
Endpoint(s): Please cf Protocol (there is too many caracters to be put here)

Source: https://euclinicaltrials.eu/ctis-public/view/2024-511713-38-00